EU clinical trial 2025-522290-11-00: IMAGINE 1
Protocol code: K 2025-3714
Sponsor: Karolinska University Hospital (Hospital/Clinic/Other health care facility). Phase: Human Pharmacology (Phase I)- Other. Countries: Sweden (ongoing, recruiting).
Therapeutic area(s): Diseases [C] - Digestive System Diseases [C06]; Diseases [C] - Neoplasms [C04]; Analytical, Diagnostic and Therapeutic Techniques and Equipment [E] - Investigative Techniques [E05]; Analytical, Diagnostic and Therapeutic Techniques and Equipment [E] - Diagnosis [E01]
Gender: Female, Male. Age: 18-64 years, 65+ years. Enrolment: 20.
Status: Ongoing, recruiting. Start date (EU): 2025-11-18. Decision date: 2025-09-30. Results received: No. Last updated: 2025-09-30.

Condition(s): Cholangiocarcinoma, pancreatic cancer, colo-rectal cancer

Source: https://euclinicaltrials.eu/ctis-public/view/2025-522290-11-00